EU clinical trial 2025-525042-22-00: A Study to Evaluate the Safety and Activity of an Inhaled Investigational Drug (RO7616605) in Healthy Volunteers and Participants With COPD
Protocol code: GA46303
Sponsor: Genentech Inc. (Pharmaceutical company). Phase: Human Pharmacology (Phase I)- First administration to humans. Countries: Germany (authorised, recruitment pending).
Therapeutic area(s): Diseases [C] - Respiratory Tract Diseases [C08]
Gender: Female, Male. Age: 18-64 years, 65+ years. Enrolment: 104.
Status: Authorised, recruitment pending. Decision date: 2026-07-23. Results received: No. Last updated: 2026-07-28.

Condition(s): Chronic Obstructive Pulmonary Disease (COPD) and Chronic Bronchitis

Source: https://euclinicaltrials.eu/ctis-public/view/2025-525042-22-00